EU clinical trial 2023-506854-19-00: IMA401-101 – Treatment of patients with solid tumors with IMA401 TCER®, a bispecific T-cell receptor (Phase I trial); alone or in combination with checkpoint inhibitor
Protocol code: IMA401-101
Sponsor: Immatics Biotechnologies GmbH (Pharmaceutical company). Phase: Human Pharmacology (Phase I)- First administration to humans. Countries: Germany (ongoing, recruitment ended).
Therapeutic area(s): Diseases [C] - Neoplasms [C04]
Gender: Female, Male. Age: 18-64 years, 65+ years. Enrolment: 95.
Status: Ongoing, recruitment ended. Start date (EU): 2022-05-19. Decision date: 2023-09-28. Results received: No. Last updated: 2026-03-10.

Condition(s): Solid Tumors

Source: https://euclinicaltrials.eu/ctis-public/view/2023-506854-19-00